EU clinical trial 2023-504045-31-00: A Phase 2a Multicenter, Randomized, Double Blind, Parallel-group, Proof of Concept Study Evaluating the Efficacy and Safety of Nipocalimab and Certolizumab Combination Therapy in Subjects with Active Rheumatoid Arthritis despite Prior Treatment with Advanced Therapies (bDMARD or tsDMARD)
Protocol code: 80202125ARA2002
Sponsor: Janssen - Cilag International (Pharmaceutical company). Phase: Therapeutic exploratory (Phase II). Countries: Germany (ended), Poland (ended), Hungary (ended).
Therapeutic area(s): Diseases [C] - Immune System Diseases [C20]
Gender: Female, Male. Age: 18-64 years, 65+ years. Enrolment: 55.
Status: Ended. Start date (EU): 2024-02-08. End date (EU): 2024-10-29. End date: 2024-10-30. Decision date: 2023-10-09. Results received: Yes. Last updated: 2024-10-16.
Decision dates by country: DE: 2023-10-09, HU: 2023-10-09, PL: 2023-10-09

Condition(s): Rheumatoid Arthritis
Product: FOLIC ACID, METHOTREXATE, SULFASALAZINE, CHLOROQUINE, HYDROXYCHLOROQUINE, CALCIUM FOLINATE, PARACETAMOL, Cimzia 200 mg solution for injection in pre-filled syringe, Saline, 0.9% Sodium Chloride Solution for Injection, LEFLUNOMIDE, JNJ-80202135

Primary endpoint: Change from baseline in DAS28-CRP at Week 12

Source: https://euclinicaltrials.eu/ctis-public/view/2023-504045-31-00